EU clinical trial 2024-515774-27-00: AntiPlatelet theraPy stratEgy followiNg left atrial appenDAGe closurE
Protocol code: CHUBX2017/29
Sponsor: Centre Hospitalier Universitaire De Bordeaux (Hospital/Clinic/Other health care facility). Phase: Therapeutic use (Phase IV). Countries: France (ongoing, recruiting).
Therapeutic area(s): Diseases [C] - Cardiovascular Diseases [C14]
Gender: Female, Male. Age: 18-64 years, 65+ years. Enrolment: 60.
Status: Ongoing, recruiting. Start date (EU): 2024-09-03. Decision date: 2024-09-03. Results received: No. Last updated: 2025-06-12.

Condition(s): Atrial Fibrillation, atrial appendage, anticoagulants, stroke, platelet aggregation inhibitors
Product: KARDEGIC 160 mg, poudre pour solution buvable en sachet, Plavix 75 mg film-coated tablets

Primary endpoint: The primary end point is the number of ischemic lesions appearing on the diffusion sequences and/or FLAIR between cerebral MRI scans performed within 24 hours of the procedure and after 3 months of anti-thrombotic treatment.
Endpoint(s): Symptomatic ischemic cerebral events (cerebral infarction and transient ischemic attacks) identified by MRI and systematic neurological examination at D1 and M3, and at any time in the event of a symptomatic event, Systemic thromboembolic events that will be identified when clinically symptomatic, Cerebral hemorrhagic events that will be identified by MRI (T2 sequence*) and by systematic neurological examination at D1 and M3, and at any time in the event of a symptomatic event., Systemic bleeding events that will be identified when clinically symptomatic, Neurological deficits and their functional impact, which will be measured with the NIHSS (National Institute of Health Stroke Score) and by the modified Rankin score at each post-implantation assessment time (D1 and M3), Cognitive assessment of patients using the Montreal Cognitive Assessment (MoCA) scale at D1 and M3, Events related to the prosthesis embolization procedure and severe pericardial effusion which will be objectified by clinical evaluation and ultrasound examination, The presence of thrombus on the prosthesis, the existence of residual leakage and the degree of endothelialization which will be evaluated by cardiac CT scan at 3 months, Treatment compliance will be assessed at M3 for all patients by accounting for treatments taken compared to those that should have been taken. This compliance will be correlated with thromboembolic and haemorrhagic events in order to define the accountability of the treatment strategy on these events

Source: https://euclinicaltrials.eu/ctis-public/view/2024-515774-27-00